EU clinical trial 2025-523820-26-00: A Multicenter, 12-Month, Randomized, Double Blind, Placebo-Controlled Phase 3 Efficacy and Safety Study of Daily Oral LUM 201 in Naïve-to-Treatment, Prepubertal Children with Growth Hormone Deficiency (GHD)
Protocol code: LUM-201-10
Sponsor: Lumos Pharma LLC (Pharmaceutical company). Phase: Therapeutic confirmatory (Phase III). Countries: Romania (not authorised), France (not authorised), Italy (not authorised), Poland (not authorised), Spain (not authorised).
Therapeutic area(s): Diseases [C] - Hormonal diseases [C19]
Gender: Female, Male. Age: 0-17 years. Enrolment: 57.
Status: Not authorised. Decision date: 2026-02-18. Results received: No. Last updated: 2026-02-23.
Decision dates by country: ES: 2026-02-19, FR: 2026-02-22, IT: 2026-02-18, RO: 2026-02-23, PL: 2026-02-22

Condition(s): Growth Hormone Deficiency (GHD)
Product: Ibutamoren Mesylate, Ibutamoren Mesylate, Matched placebo capsules administered orally once per day, Ibutamoren Mesylate

Primary endpoint: AHV from Day 1 to Month 12 in the LUM-201 and placebo arms
Endpoint(s): • Change from baseline in IGF-1 SDS, • Change from baseline in HT-SDS, • Change from baseline in IGFBP-3 SDS, • IGF-1 SDS, • HT SDS, • IGFBP-3 SDS

Source: https://euclinicaltrials.eu/ctis-public/view/2025-523820-26-00